EU clinical trial 2022-500903-38-00: Phase 1b study investigating the association of NP137 with Atezolizumab-Bevacizumab combination in first line in unresectable hepatocellular carcinoma
Protocol code: 38RC22.210 LIVERNET1
Sponsor: University Hospital Grenoble (Hospital/Clinic/Other health care facility). Phase: Human Pharmacology (Phase I)- Other. Countries: France (ongoing, recruitment ended).
Therapeutic area(s): Diseases [C] - Digestive System Diseases [C06]
Gender: Female, Male. Age: 18-64 years, 65+ years. Enrolment: 52.
Status: Ongoing, recruitment ended. Start date (EU): 2023-02-09. Decision date: 2022-11-15. Results received: No. Last updated: 2026-05-22.

Condition(s): unresectable hepatocellular carcinoma

Source: https://euclinicaltrials.eu/ctis-public/view/2022-500903-38-00